EU clinical trial 2025-524573-16-00: OPTIMAL CARE WITH GUSELKUMAB IN CROHN’S DISEASE
Protocol code: GETAID 2025-03
Sponsor: i-GETAID (Laboratory/Research/Testing facility). Phase: Therapeutic use (Phase IV). Countries: France (ongoing, recruiting).
Therapeutic area(s): Diseases [C] - Digestive System Diseases [C06]
Gender: Female, Male. Age: 18-64 years. Enrolment: 210.
Status: Ongoing, recruiting. Start date (EU): 2026-06-11. Decision date: 2026-04-16. Results received: No. Last updated: 2026-04-16.

Condition(s): Crohn's disease
Product: Guselkumab - solution for injection in pre-filled syringe - 100 mg/mL, Guselkumab

Primary endpoint: Steroid free clinical remission (SFCR) associated with fecal calprotectin < 250 ug/g at W48
Endpoint(s): Morphological remission at W48 assessed using the same tool that was used for the patient’s inclusion: endoscopy, MRI or IUS (major secondary endpoint), SFCR associated with fecal calprotectin < 250 ug/g at W12, W24 and W48, Clinical remission at W12, W24, and W48, Clinical response at W12, Biomarker remission at W12, W24, and W48, Need for guselkumab dose intensification (W12, W24, W48), Change in Short IBD-Q (quality of life index) from baseline (W12, W24, and W48)

Source: https://euclinicaltrials.eu/ctis-public/view/2025-524573-16-00